EU clinical trial 2023-510039-12-00: Dopamine agonist treatment of non-functioning pituitary adenomas (NFPAs) – a randomized controlled trial
Sponsor: St. Olavs Hospital HF (Hospital/Clinic/Other health care facility). Phase: Therapeutic use (Phase IV). Countries: Norway (ongoing, recruitment ended).
Therapeutic area(s): Diseases [C] - Neoplasms [C04]
Gender: Female, Male. Age: 18-64 years, 65+ years. Enrolment: 60.
Status: Ongoing, recruitment ended. Start date (EU): 2014-09-01. Decision date: 2024-11-18. Results received: No. Last updated: 2024-11-18.

Condition(s): Non-functioning pituitary adenoma
Product: Dostinex 0,5 mg tabletter

Primary endpoint: • The change in tumour volume during the main study of two years. This includes the percentage and absolute change in tumour volume, but also the number of patients with significant tumour shrinkage or tumour growth (defined by ≥ 10 % or ≥ 2 mm shrinkage/growth in at least one dimension).
Endpoint(s): • The need for surgical and/or radiation treatment during the study period • The development of new pituitary failure or changed pituitary function during the study, or new or changed visual field defects or other cranial nerve affections • The change in tumour’s distance to chiasma opticum (mm) • The response on gonadotropins (FSH, LH) and/or their subunits, particularly the α-subunit. A possible correlation between the tumour size response and the hormone levels and change during treatment

Source: https://euclinicaltrials.eu/ctis-public/view/2023-510039-12-00